EU clinical trial 2024-517388-22-00: Phase 2/3, Double-blind, Placebo-controlled Study to Evaluate the Safety and Efficacy of EXV-802 and EXV-801 in the Treatment of Agitation in Participants with Alzheimer’s Disease Dementia
Protocol code: EXV802-2-1
Sponsor: Exciva GmbH (Pharmaceutical company). Phase: Phase II and Phase III (Integrated). Countries: Italy (authorised, recruitment pending), Slovakia (authorised, recruitment pending), Spain (authorised, recruitment pending), Poland (authorised, recruitment pending), Czechia (authorised, recruitment pending), Germany (authorised, recruitment pending).
Therapeutic area(s): Diseases [C] - Nervous System Diseases [C10]
Gender: Female, Male. Age: 18-64 years, 65+ years. Enrolment: 222.
Status: Authorised, recruitment pending. Decision date: 2026-04-28. Results received: No. Last updated: 2026-05-04.
Decision dates by country: CZ: 2026-04-28, ES: 2026-05-04, PL: 2026-04-30, SK: 2026-04-29, DE: 2026-04-30, IT: 2026-04-28

Condition(s): Agitation in Alzheimer's Disease Dementia
Product: EXV-802, EXV-801, Matching Placebo

Primary endpoint: Difference between active and placebo as measured by changes from baseline to endpoint (Week 6) in the Cohen-Mansfield Agitation Inventory total score
Endpoint(s): EXV-802: Difference between active and placebo as measured by changes from baseline to endpoint (Week 6) in the Clinical Global Impression of Severity of Illness (CGI-S) score, as related to symptoms of agitation., EXV-802: Difference between active and placebo as measured by changes from baseline to endpoint (Week 6) in the NPI-C Caregiver Distress total score for agitation and aggression., EXV-802: Difference between active and placebo as measured by changes from baseline to endpoint (Week 6) in the NPI-C Irritability / Lability score., EXV-802: Difference between active and placebo as measured by changes from baseline to endpoint (Week 6) in the NPI-C Sleep Disorders score., EXV-802: Difference between active and placebo in frequency and severity of adverse events and clinically relevant changes in relevant safety endpoints e.g.: • Mini‐Mental State Examination (MMSE) • Columbia Suicide Severity Rating Scale (C-SSRS) score • Clinical laboratory values • Vital signs • Electrocardiograms (ECGs) • Physical examination findings, EXV-801: Difference between active and placebo as measured by changes from baseline to endpoint (Week 6) in CMAI, CGI-S, NPI-C, exploratory PD markers (BDNF), and blood-based biomarkers (analysis limited to descriptive statistics, including the effect size)., EXV-801: Difference between active and placebo in frequency and severity of adverse events and clinically relevant changes in relevant safety endpoints e.g.: • Mini‐Mental State Examination (MMSE) • Columbia Suicide Severity Rating Scale (C-SSRS) score • Clinical laboratory values • Vital signs • Electrocardiograms (ECGs) • Physical examination findings

Source: https://euclinicaltrials.eu/ctis-public/view/2024-517388-22-00